EU clinical trial 2023-506228-10-00: An Open-label, Phase I/II First-in-Human, Dose Escalation and Cohort Expansion Study to Evaluate the Safety, Tolerability, Pharmacokinetic, Pharmacodynamic and Anti-tumor Activity of ERK1/2 Inhibitor IPN01194 as Single Agent in Adult Participants with Advanced Solid Tumors
Protocol code: CLIN-01194-450
Sponsor: Ipsen Pharma (Pharmaceutical company). Phase: Phase I and Phase II (Integrated)- First administration to humans. Countries: Spain (ended), France (ongoing, recruitment ended).
Therapeutic area(s): Diseases [C] - Neoplasms [C04]
Gender: Female, Male. Age: 18-64 years, 65+ years. Enrolment: 36.
Start date (EU): 2024-06-27. Decision date: 2024-04-24. Results received: No. Last updated: 2026-05-04.
Decision dates by country: ES: 2024-04-24, FR: 2024-05-02

Condition(s): Pancreatic Ductal Adenocarcinoma, Melanoma, Head and Neck Squamous Cell Carcinoma, Colorectal Cancer, Solid tumors

Primary endpoint: Phase 1: Percentage of participants with dose limiting toxicity (DLT) [Time Frame: Cycle 1: Day 1 to Day 28], Phase 1: Percentage of participants experiencing treatment-emergent adverse events (TEAEs) and treatment-emergent serious adverse events (TE SAEs). An Adverse event (AE) is any untoward medical occurrence in a clinical study participant, temporally associated with the use of study intervention, whether or not considered related to the study intervention. [Time Frame: From Cycle 1 Day 1 to 30 days following the last administration of study intervention], Phase 1: Percentage of participants with dose interruptions and permanent treatment discontinuations [Time Frame: From Cycle 1 Day 1 to 30 days following the last administration of study intervention], Phase 2a: Objective response rate (ORR) Defined as the percentage of participants with best overall response (BOR) of complete response (CR) or partial response (PR) as determined by investigator. [Time Frame: Cycle 1 Day 1 to 12 weeks (up to approximately 32 months)]
Endpoint(s): Phase 1: Time to maximum observed drug concentration (Tmax) after single and multiple doses of IPN01194 [Time Frame: Cycle 1 Day 1 to Day 28], Phase 1: Maximum observed drug concentration (Cmax) after single and multiple doses of IPN01194 [Time Frame: Cycle 1 Day 1 to Day 28], Phase 1: Area under the plasma concentration time curve (AUCtau) after single and multiple doses of IPN01194. AUCtau is defined as the concentration of drug over one dosing interval. [Time Frame: Cycle 1 Day 1 to Day 28], Phase 1: Geometric mean ratio of Cmax of IPN01194 administered in fed state relative to fasted state [Time Frame: From Day -10 to Day -1 before baseline (Cycle 1 Day 1)], Phase 1: Geometric mean ratio of AUClast of IPN01194 administered in fed state relative to fasted state. AUClast is defined as the concentration of drug from time zero to the last observable concentration. [Time Frame: From Day -10 to Day -1 before baseline (Cycle 1 Day 1)], Phase 1: Geometric mean ratio of AUCinf administered in fed state relative to fasted state. AUCinf is defined as the concentration of drug extrapolated to infinite time. [Time Frame: From Day -10 to Day -1 before baseline (Cycle 1 Day 1)], Phase 1: Prolongation of corrected QT interval (QTc). Prolongation of QTc defined as the upper limit of 90% confidence interval for change from baseline QTc evaluated over Cycle 1 at the highest clinically relevant exposure. [Time Frame: Cycle 1 Day 1 to Day 28], Phase 1: Objective response rate (ORR). The ORR is defined as the percentage of participants with best overall response (BOR) of complete response (CR) or partial response (PR). [Time Frame: Cycle 1 Day 1 to 12 weeks], Phase 2a: Duration of response (DoR). Defined as the percentage of participants with BOR of CR or PR, as determined by investigator per RECIST version 1.1 [Time Frame: From randomisation to end of treatment (up to approximately 32 months)], Phase 2a: Progression-free survival (PFS). PFS is defined as the time from the date of randomisation to the date of the first documented disease progression, as determined by investigator per RECIST version 1.1. [Time Frame: From randomisation to end of treatment (approximately 32 months)], Phase 2a: PFS rate at 4 months [Time Frame: From randomisation to 4 months], Phase 2a: DCR. DCR is defined as the percentage of participants with BOR of CR, PR or SD, as determined by investigator per RECIST version 1.1. [Time Frame: Cycle 1 Day 1 to end of treatment (approximately 32 months)], Phase 2a: Percentage of participants with TEAEs and TE SAEs [Time Frame: Cycle 1 Day 1 to end of treatment (up to approximately 32 months)], Phase 2a: Percentage of participants with dose interruptions and permanent treatment discontinuations [Time Frame: Cycle 1 Day 1 to end of treatment (up to approximately 32 months)]

Source: https://euclinicaltrials.eu/ctis-public/view/2023-506228-10-00